EU clinical trial 2025-520519-14-00: A Phase III, Randomised, Double-blind, Placebo-controlled, Parallel-group Study to Assess the Effect of AZD0780 on Major Adverse Cardiovascular Events in Patients with Established Atherosclerotic Cardiovascular Disease (ASCVD) or at High Risk for a First ASCVD Event
Protocol code: D7960C00015
Sponsor: AstraZeneca AB (Pharmaceutical company). Phase: Therapeutic confirmatory (Phase III). Countries: Greece (ongoing, recruiting), Hungary (ongoing, recruiting), Poland (ongoing, recruiting), Germany (ongoing, recruiting), Slovakia (ongoing, recruiting), Denmark (ongoing, recruiting), Bulgaria (ongoing, recruiting), Spain (ongoing, recruiting), Italy (ongoing, recruiting), Sweden (ongoing, recruiting), France (ongoing, recruiting), Romania (ongoing, recruiting), Czechia (ongoing, recruiting).
Therapeutic area(s): Diseases [C] - Cardiovascular Diseases [C14]
Gender: Female, Male. Age: 18-64 years, 65+ years. Enrolment: 3531.
Status: Ongoing, recruiting. Start date (EU): 2025-09-03. Decision date: 2025-08-26. Results received: No. Last updated: 2026-05-29.
Decision dates by country: RO: 2025-09-01, DE: 2025-08-27, BG: 2025-08-28, GR: 2025-08-26, ES: 2025-09-01, IT: 2025-08-26, PL: 2025-08-29, FR: 2025-08-28, HU: 2025-08-29, CZ: 2025-10-02, DK: 2025-08-26, SE: 2025-08-27, SK: 2025-08-26

Condition(s): Atherosclerotic Cardiovascular Disease
Product: AZD0780, AZD0780 placebo

Primary endpoint: Time to first event of any component of MACE PLUS
Endpoint(s): Time to first event of any component of 3P MACE, Time to first event of any component of MACE PLUS in participants with a prior history of ASCVD, Time to first event of MI, Time to first event of urgent coronary revascularisation, Time to CV death, Time to first event of MALE, Time to all-cause mortality

Source: https://euclinicaltrials.eu/ctis-public/view/2025-520519-14-00